EU clinical trial 2023-510351-31-00: A Randomized, Double-Blind, Placebo-Controlled, Multiple Ascending Dose Study Assessing Safety, Tolerability, Pharmacodynamics, Efficacy, and Pharmacokinetics of DYNE-251 Administered to Participants with Duchenne Muscular Dystrophy Amenable to Exon 51 Skipping
Protocol code: DYNE251-DMD-201
Sponsor: Dyne Therapeutics Inc. (Pharmaceutical company). Phase: Phase I and Phase II (Integrated)- First administration to humans. Countries: Spain (ongoing, recruitment ended), Italy (ongoing, recruitment ended), Ireland (ongoing, recruitment ended), Belgium (ongoing, recruitment ended).
Therapeutic area(s): Diseases [C] - Musculoskeletal Diseases [C05]
Gender: Male. Age: 0-17 years. Enrolment: 16.
Status: Ongoing, recruitment ended. Start date (EU): 2023-01-06. Decision date: 2024-07-09. Results received: No. Last updated: 2026-04-17.
Decision dates by country: BE: 2024-07-16, IT: 2024-07-16, ES: 2024-07-09, IE: 2024-07-09

Condition(s): Duchenne muscular dystrophy
Product: The placebo is commercially available 5% dextrose solution intended for IV, DYNE-251, DYNE-251

Primary endpoint: Number and proportion of participants with treatment-emergent adverse events (TEAEs), treatment emergent serious adverse events (TESAEs), TEAEs considered related to study drug, and TEAEs leading to discontinuation from study drug and discontinuation from the study., Change from Baseline in dystrophin protein levels in muscle tissue as determined by Western blot analysis at Week 25
Endpoint(s): Muscle Tissue Endpoints: Cohorts dosed Q4W or Q8W with a second biopsy at Week 25, Change from Baseline at Week 25: -exon 51 skipping levels in muscle tissue -PDPF in muscle tissue -PMO concentration in muscle tissue, Change from baseline up to Week 145: -blood CK levels, Cohorts dosed Q8W with a second biopsy at Week 49 Change from Baseline at Week 49 in: -dystrophin protein levels in muscle tissue -exon 51 skipping levels in muscle tissue -PDPF in muscle tissue -PMO concentration in muscle tissue, Change from Baseline up to Week 145 in: -blood CK level, Functional Endpoints: All cohorts, Change from Baseline up to Week 145 in: -PUL scale V 2.0 score -%pFVC -NSAA total score, TTR, 10MRW, and SV95C in ambulatory participants, Plasma Endpoints: All cohorts -Cmax -tmax -AUCtlast -AUC∞ -λZ -t½ -CL -Vz and Vss, if appropriate, Immunogenicity Endpoint: All cohorts -Incidence of ADAs

Source: https://euclinicaltrials.eu/ctis-public/view/2023-510351-31-00